EU clinical trial 2024-513435-24-01: J4F-MC-CYAB: A Phase 2, Randomized, Double-Blind, Placebo Controlled, Dose-Finding Study Evaluating LY3848575 in Chronic Neuropathic Pain Associated With Distal Sensory Polyneuropathy
Protocol code: J4F-MC-CYAB
Sponsor: Eli Lilly & Co. (Pharmaceutical company). Phase: Therapeutic exploratory (Phase II). Countries: Germany (ended), Poland (ended).
Therapeutic area(s): Diseases [C] - Nervous System Diseases [C10]
Gender: Female, Male. Age: 18-64 years, 65+ years. Enrolment: 67.
Status: Ended. Start date (EU): 2025-06-03. End date (EU): 2026-04-07. End date: 2026-04-15. Decision date: 2025-05-23. Results received: No. Last updated: 2026-06-11.
Decision dates by country: DE: 2025-05-23, PL: 2025-06-13

Condition(s): Neuropathic Pain; Distal Sensory Polyneuropathy
Product: Placebo to match LY3848575

Primary endpoint: Mean Change from Baseline in Average Pain Intensity Numeric Rating Scale (API-NRS)

Source: https://euclinicaltrials.eu/ctis-public/view/2024-513435-24-01